EU clinical trial 2024-516317-21-00: A placebo-controlled trial with prucalopride for the treatment of typical reflux symptoms in patients with gastro-esophageal reflux disease with incomplete proton pump inhibitor response.
Sponsor: UZ Leuven (Hospital/Clinic/Other health care facility). Phase: Therapeutic use (Phase IV). Countries: Belgium (ongoing, recruiting).
Therapeutic area(s): Phenomena and Processes [G] - Digestive System and Oral Physiological Phenomena [G10]
Gender: Female, Male. Age: 18-64 years. Enrolment: 60.
Status: Ongoing, recruiting. Start date (EU): 2018-04-09. Decision date: 2024-10-10. Results received: No. Last updated: 2024-10-10.

Condition(s): gastro-esophageal reflux disease
Product: Prucalopride Prolepha 2 mg filmomhulde tabletten, Placebo tablet manufactured by Laboratoria Wolfs, Zwijndrecht. Ingredients (1 tablet, 488mg): Lactose monohydrate 320mg; Carmellose sodium 10mg; Corn starch 70mg; Cellulose microcrystalline 55mg; Silicium dioxide anhydrous 20mg; Magnesium stearate 13mg

Primary endpoint: Change in acid exposure time assessed by 24 hour impedance-pH monitoring
Endpoint(s): Change in number of reflux episodes assessed by 24 hour impedance-pH monitoring, Change in motility patterns in the esophagus assessed by high resolution and impedance manometry, Change in symptom severity assessed by a reflux questionnaire (Request)

Source: https://euclinicaltrials.eu/ctis-public/view/2024-516317-21-00